EU clinical trial 2024-514099-41-00: Multicentre, Randomized, Double-blind, Placebo-controlled Trial Evaluating the Effect of a 30-week Caffeine Treatment on Cognition in Alzheimer's Disease at Beginning to Moderate Stages. Effect of CAFeine on Cognition in Alzheimer's Disease ( CAFCA )
Protocol code: 2018_95
Sponsor: Centre Hospitalier Universitaire De Lille (Hospital/Clinic/Other health care facility). Phase: Therapeutic confirmatory (Phase III). Countries: France (ongoing, recruiting).
Therapeutic area(s): Diseases [C] - Nervous System Diseases [C10]
Gender: Female, Male. Age: 18-64 years, 65+ years. Enrolment: 248.
Status: Ongoing, recruiting. Start date (EU): 2024-10-31. Decision date: 2024-10-31. Results received: No. Last updated: 2025-08-12.

Condition(s): Alzheimer's disease
Product: Cafeine anhydre, Microcrystalline cellulose 200mg, Cafeine anhydre, Microcrystalline cellulose 100mg

Primary endpoint: Variation in total NTB score (z-score) at 30 weeks post-randomization (difference between randomized value and value after 30 weeks of treatment)
Endpoint(s): For evaluation of the effect of caffeine compared to placebo 30 weeks after randomization 1.1) On cognitive functions, variation between baseline (randomization) and V5 (30 weeks after randomization) of the following parameters: - MMSE score - NTB executive functions sub-score - NTB memory sub-score o Simple reaction time to TAP test - Complex reaction time in the TAP test o Epworth score 1.2) Functional autonomy, variation between the baseline and V4 (30 weeks after randomisation) of the DAD, To evaluate the persistent effect of caffeine treatment 6 weeks after its interruption (visit V5, 36 weeks after randomisation): variation of the previous parameters (except the CGIC score) between the baseline and V5 ; CGIC score at V5, Heterogeneity of the effect of caffeine treatment On the following pre-defined subgroups: iAChE treatment (yes / no), APOE4 genotype (homo / hetero / null), caffeine metabolism (slow / fast) and gender (male / female); the variation of the NTB score (main criterion) between the baseline and the V4 visit., Evaluate the effect of caffeine compared to placebo on the occurrence of adverse events during follow-up (from randomization to visit V5) Evolution during follow-up of NPI scores, NPI-R sleep, NPI-R anxiety, heart rate, blood pressure., Evaluate the effect of caffeine compared to placebo on the increase of caffeine and its three dimethylated metabolites (paraxanthine, theophylline, theobromine) in the morning on an empty stomach Evolution during the monitoring of the value of caffeine and the concentration of its three dimethylated metabolites (paraxanthine, theophylline, theobromine) in the morning on an empty stomach.

Source: https://euclinicaltrials.eu/ctis-public/view/2024-514099-41-00